EU clinical trial 2025-524480-21-00: The clinical trial to study a new drug, AP-2.
Protocol code: MOLEFY-AP-2-2025-PHA
Sponsor: Molefy Pharma S.L. (Pharmaceutical company). Phase: Human Pharmacology (Phase I)- First administration to humans. Countries: Spain (ongoing, recruiting).
Therapeutic area(s): Diseases [C] - Nervous System Diseases [C10]
Gender: Male. Age: 18-64 years. Enrolment: 72.
Status: Ongoing, recruiting. Start date (EU): 2026-04-24. Decision date: 2026-03-10. Results received: No. Last updated: 2026-04-24.

Condition(s): ALS and related disorders like frontotemporal dementia and Alexander disease.

Source: https://euclinicaltrials.eu/ctis-public/view/2025-524480-21-00